EU clinical trial 2026-525355-93-00: PHASE III, OPEN-LABEL, RANDOMIZED, CONTROLLED, NON-INFERIORITY CLINICAL-TRIAL TO ASSESS THE EFFICACY AND SAFETY OF SHORT OUTPATIENT AMOXICILLIN REGIMENS IN CHILDREN WITH ACUTE STREPTOCOCCAL PHARYNGOTONSILLITIS (STOP – TRIAL)
Protocol code: FIBHNJ-2025-001
Sponsor: Fundacion Para La Investigacion Biomedica Hospital Infantil Universitario Nino Jesus (Hospital/Clinic/Other health care facility). Phase: Therapeutic confirmatory (Phase III). Countries: Spain (authorised, recruitment pending).
Therapeutic area(s): Diseases [C] - Bacterial Infections and Mycoses [C01]
Gender: Female, Male. Age: 0-17 years. Enrolment: 500.
Status: Authorised, recruitment pending. Decision date: 2026-06-08. Results received: No. Last updated: 2026-06-08.

Condition(s): ACUTE STREPTOCOCCAL PHARYNGOTONSILLITIS
Product: AMOXICILLIN

Primary endpoint: Relapse: patients with reinfection by EbhGA within 15 days after completing the assigned antibiotic regimen.
Endpoint(s): Cure: number of patients with fever resolution 48 hours after starting the assigned antibiotic regimen., Suppurative complications. Suppurative complications are defined as: o Acute cellulitis. o Acute otitis media. o Acute sinusitis. o Acute mastoiditis. o Acute suppurative cervical adenitis. o Acute peritonsillar or retropharyngeal abscess. o Acute meningitis. o Acute cerebral abscess. o Acute thrombosis of the intracranial venous sinuses. o Acute streptococcal pneumonia. o Acute suppurative arthritis. o Acute osteomyelitis. o Acute liver abscess. o Acute endocarditis., Non-suppurative complications. Non-suppurative complications are defined as: o Acute rheumatic fever (Diagnostic criteria - Appendix B). o Acute post-streptococcal glomerulonephritis. o Acute post-streptococcal reactive arthritis. o Erythema nodosum. o Anaaphylactoid purpura. o PANDAS syndrome., New episodes of streptococcal FAA: presence of new episodes with TDR or positive throat culture for EbhGA during the 4-month follow-up period.

Source: https://euclinicaltrials.eu/ctis-public/view/2026-525355-93-00